EU clinical trial 2025-522207-15-01: An Open-label, Multicenter, Two Part, Ascending Dose Followed by a Controlled Trial to Assess the Safety and Efficacy of a Subretinal Administration of AAVB-039 in Participants with Stargardt Disease (STGD1) (CELESTE)
Protocol code: 039-101
Sponsor: Aavantgarde Bio S.r.l. (Pharmaceutical company). Phase: Phase I and Phase II (Integrated)- First administration to humans. Countries: Belgium (authorised, recruitment pending), Italy (authorised, recruitment pending), Netherlands (authorised, recruitment pending), Norway (authorised, recruitment pending).
Therapeutic area(s): Diseases [C] - Eye Diseases [C11]; Diseases [C] - Congenital, Hereditary, and Neonatal Diseases and Abnormalities [C16]
Gender: Female, Male. Age: 0-17 years, 18-64 years. Enrolment: 21.
Status: Authorised, recruitment pending. Decision date: 2026-04-10. Results received: No. Last updated: 2026-05-21.
Decision dates by country: IT: 2026-04-14, BE: 2026-04-10, NL: 2026-04-15, NO: 2026-04-13

Condition(s): Stargardt Disease (STGD1)
Product: AAVB-039

Primary endpoint: To measure the number and severity of treatment related adverse events following treatment with AAVB-039
Endpoint(s): Change in the area of atrophy (assessed via short wavelength fundus autofluorescence (SW-FAF), following treatment with AAVB-039., Change in ellipsoid zone (EZ) loss following treatment with AAVB-039., Change in macular sensitivity assessed via microperimetry following treatment with AAVB-039, Change in visual acuity following treatment with AAVB-039

Source: https://euclinicaltrials.eu/ctis-public/view/2025-522207-15-01